EU clinical trial 2023-509687-14-00: Phase 1 Study of PYX-201 in Solid Tumors
Protocol code: PYX-201-101
Sponsor: Pyxis Oncology Inc. (Pharmaceutical company). Phase: Human Pharmacology (Phase I)- First administration to humans. Countries: Spain (ongoing, recruiting), Belgium (ongoing, recruiting).
Therapeutic area(s): Diseases [C] - Neoplasms [C04]
Gender: Female, Male. Age: 18-64 years, 65+ years. Enrolment: 90.
Status: Ongoing, recruiting. Start date (EU): 2024-08-29. Decision date: 2023-12-21. Results received: No. Last updated: 2026-05-08.
Decision dates by country: BE: 2023-12-21, ES: 2023-12-29

Condition(s): Advanced solid tumors

Source: https://euclinicaltrials.eu/ctis-public/view/2023-509687-14-00